EU clinical trial 2023-504830-23-00: A Randomized, Open-Label, Phase 3 Trial of Epcoritamab vs Investigator’s Choice Chemotherapy in Relapsed/Refractory Diffuse Large B-cell Lymphoma
Protocol code: GCT3013-05
Sponsor: Genmab A/S (Pharmaceutical company). Phase: Therapeutic confirmatory (Phase III). Countries: Spain (ongoing, recruitment ended), France (ongoing, recruitment ended), Austria (ended), Poland (ongoing, recruitment ended), Netherlands (ongoing, recruitment ended), Belgium (ongoing, recruitment ended), Italy (ongoing, recruitment ended), Denmark (ongoing, recruitment ended), Sweden (ongoing, recruitment ended), Norway (ongoing, recruitment ended), Hungary (ongoing, recruitment ended), Germany (ongoing, recruitment ended), Finland (ongoing, recruitment ended).
Therapeutic area(s): Diseases [C] - Neoplasms [C04]
Gender: Female, Male. Age: 18-64 years, 65+ years. Enrolment: 253.
Start date (EU): 2020-12-16. Decision date: 2024-02-07. Results received: No. Last updated: 2026-07-20.
Decision dates by country: AT: 2024-02-07, PL: 2024-03-04, HU: 2024-02-08, DE: 2024-02-09, DK: 2024-02-07, BE: 2024-02-15, IT: 2024-03-01, NL: 2024-02-09, SE: 2024-02-08, FI: 2024-02-12, NO: 2024-02-08, ES: 2024-02-07, FR: 2024-03-01

Condition(s): B-cell Lymphoma
Product: OXALIPLATIN, ANAKINRA, TOCILIZUMAB, Epcoritamab, DIPHENHYDRAMINE, DEXAMETHASONE, BENDAMUSTINE, Epcoritamab, GEMCITABINE, PARACETAMOL, SILTUXIMAB, RITUXIMAB

Primary endpoint: Overall survival (OS), Progression-free survival (PFS) determined by Lugano criteria per independent review committee (IRC) assessment
Endpoint(s): Progression-free survival (PFS) determined by Lugano criteria per investigator assessment, Overall response rate (ORR) determined by Lugano criteria per IRC assessment and investigator assessment, Complete response (CR) rate determined by Lugano criteria per IRC assessment and investigator assessment, Duration of response (DOR) determined by Lugano criteria per IRC assessment and investigator assessment, Time to response (TTR) determined by Lugano criteria per IRC assessment and investigator, Rate and duration of minimal residual disease (MRD) negative status, PFS determined by Lymphoma Response to Immunomodulatory Therapy Criteria (LYRIC) per IRC assessment, ORR determined by LYRIC per IRC assessment, CR rate determined by LYRIC per IRC assessment, DOR determined by LYRIC per IRC assessment, TTR determined by LYRIC per IRC assessment, Time to next anti-lymphoma therapy (TTNT), Incidence and severity of adverse events (AEs), Incidence and severity of changes in laboratory values, Incidence of dose interruptions and delays, Anti-epcoritamab antibody response, Changes in lymphoma symptoms as measured by the Functional Assessment of Cancer Therapy – Lymphoma (FACT-Lym)

Source: https://euclinicaltrials.eu/ctis-public/view/2023-504830-23-00